EU clinical trial 2023-506926-35-00: ZEUS - Effects of ziltivekimab versus placebo on cardiovascular outcomes in participants with established atherosclerotic cardiovascular disease, chronic kidney disease and systemic inflammation
Protocol code: EX6018-4758
Sponsor: Novo Nordisk A/S (Pharmaceutical company). Phase: Therapeutic confirmatory (Phase III). Countries: Denmark (ended), Lithuania (ended), Netherlands (ended), Hungary (ended), Poland (ended), Bulgaria (ended), Germany (ended), Croatia (ended), Czechia (ended), Spain (ended), Romania (ended), Italy (ended), Slovakia (ended), Sweden (ended), Portugal (ended), Latvia (ended), Belgium (ended), Greece (ended).
Therapeutic area(s): Diseases [C] - Cardiovascular Diseases [C14]
Gender: Female, Male. Age: 18-64 years, 65+ years. Enrolment: 2335.
Status: Ended. Start date (EU): 2021-09-24. End date (EU): 2026-06-09. End date: 2026-06-10. Decision date: 2024-04-30. Results received: No. Last updated: 2026-05-26.
Decision dates by country: LV: 2024-06-12, RO: 2024-05-08, LT: 2024-06-11, SK: 2024-04-30, NL: 2024-05-03, SE: 2024-05-02, PL: 2024-05-06, ES: 2024-05-06, PT: 2024-04-30, HU: 2024-05-03, CZ: 2024-05-02, DE: 2024-05-06, GR: 2024-06-26, IT: 2024-05-20, BE: 2024-05-06, DK: 2024-04-30, HR: 2024-04-30, BG: 2024-04-30

Condition(s): Atherosclerotic cardiovascular disease, chronic kidney disease and systemic inflammation
Product: ziltivekimab, Placebo (ziltivekimab)

Primary endpoint: Time to first occurrence of 3-point MACE, a composite endpoint consisting of CV death, non-fatal MI, and non-fatal stroke. Measured from randomisation to end-of-study.
Endpoint(s): Time to first occurrence of expanded MACE, a composite endpoint consisting of CV death, non-fatal MI, non-fatal stroke, and hospitalisation for unstable angina pectoris requiring urgent coronary revascularisation. Measured from randomisation to end-of-study., Number of heart failure hospitalisations or urgent heart failure visits or CV deaths from randomisation to end-of-study., Time to first occurrence of a composite kidney endpoint consisting of CV death, onset of persistent ≥ 40% reduction in eGFR (CKD-EPI) compared with baseline and kidney failure defined as death from kidney failure, onset of persistent eGFR< 15 mL/min/1.73 m2 (CKD-EPI), or initiation of chronic kidney replacement therapy. Measured from randomisation to end-of-study., Time to occurrence of all-cause mortality from randomisation to end-of-study., Time to first occurrence of each of the individual components of the expanded MACE endpoint and the kidney composite endpoint from randomisation to end-of-study., Time to first occurrence of MIs (fatal and non-fatal) from randomisation to end-of-study., Time to first occurrence of stroke (fatal and non-fatal) from randomisation to end-of-study., Time to first occurrence of a composite MACE endpoint consisting of all-cause mortality, non-fatal MI, and non-fatal stroke. Measured from randomisation to end-of-study., Time to first occurrence of a 4-component kidney endpoint consisting of onset of persistent ≥ 40% reduction in eGFR (CKD-EPI) compared with baseline, and kidney failure defined as death from kidney failure, onset of persistent eGFR< 15 mL/min/1.73 m2 (CKD-EPI), or initiation of chronic kidney replacement therapy. Measured from randomisation to end-of-study., Time to first occurrence of coronary revascularisation from randomisation to end-of-study., Change in UACR from randomisation to 2 years., Change in eGFR (CKD-EPI) from randomisation to 2 years., Annual rate of change in eGFR (CKD-EPI) (total eGFR slope) from randomisation to end-of-study., Change in hs-CRP from randomisation to 2 years., Change in NT-pro-BNP from randomisation to 2 years., Change in left ventricular ejection fraction (LVEF) from randomisation to 2 years., Number of events of atrial fibrillation from randomisation to end-of-study., Change in haemoglobin from randomisation to 2 years., Number of hospitalisations with infection as primary cause or death due to infection from randomisation to end-of-study., Change in Short Form 36 (SF-36) Physical Component Score (PCS) from randomisation to 2 years.

Source: https://euclinicaltrials.eu/ctis-public/view/2023-506926-35-00